EU clinical trial 2025-524434-25-00: "Contribution of 68Ga-FAPI-46 PET-CT in the initial staging of gastric cancers eligible for curative treatment" "FAPGASTRO"
Protocol code: CHUBX 2023/40
Sponsor: Centre Hospitalier Universitaire De Bordeaux (Hospital/Clinic/Other health care facility). Phase: Therapeutic exploratory (Phase II). Countries: France (authorised, recruitment pending).
Therapeutic area(s): Diseases [C] - Neoplasms [C04]; Analytical, Diagnostic and Therapeutic Techniques and Equipment [E] - Diagnosis [E01]
Gender: Female, Male. Age: 18-64 years, 65+ years. Enrolment: 40.
Status: Authorised, recruitment pending. Decision date: 2026-04-30. Results received: No. Last updated: 2026-04-30.

Condition(s): gastric cancer
Product: GalliaPharm 3.70 GBq radionuclide generator, GalliaPharm 1.85 GBq radionuclide generator, GalliaPharm 2.96 GBq radionuclide generator, GalliaPharm 2.22 GBq radionuclide generator, 68GA-FAPI-46, Galliad, 0,74 à 1,85 GBq, générateur radiopharmaceutique, GalliaPharm 2.59 GBq radionuclide generator, GalliaPharm 3.33 GBq radionuclide generator

Primary endpoint: Proportion of patients who present an appropriate change of TNM classification, determined by initial staging following the addition of 68Ga-FAPI-46 PET-CT
Endpoint(s): Proportion of patients who present an appropriate change of the N and/or M status of the TNM, determined by standard thoraco-abdominopelvic CT imaging alone, following the addition of 68Ga-FAPI-46 PET-CT, Proportion of patients who present an appropriate change of the M status of the TNM, determined by standard thoraco-abdominopelvic CT imaging alone, following the addition of 68Ga-FAPI-46 PET-CT, Proportion of patients who present an appropriate addition or removal of one of the following elements of therapeutic management : curative surgical treatment, neoadjuvant or adjuvant treatment by chemotherapy or radiotherapy, surgical resection complementary, palliative treatment by chemotherapy or other systemic treatment following the addition of 68Ga-FAPI-46 PET-CT, Average number of tumor lesions, lymph node or distant, detected by 68Ga-FAPI-46 PET-CT compared to the number of tumor lesions detected by reference staging, Cohen's kappa coefficient measuring the inter-observer reliability of 68Ga-FAPI-46 PET/CT interpretation between coordinating center and investigating center observers.

Source: https://euclinicaltrials.eu/ctis-public/view/2025-524434-25-00